EU clinical trial 2024-515343-39-00: Phase II multicenter randomized trial evaluating the association of PIPAC and systemic chemotherapy versus systemic chemotherapy alone as 1st-line treatment of Malignant Peritoneal Mesothelioma
Protocol code: PROICM 2019-03 MES
Sponsor: Institut Regional Du Cancer De Montpellier (Hospital/Clinic/Other health care facility). Phase: Therapeutic exploratory (Phase II). Countries: France (ended).
Therapeutic area(s): Diseases [C] - Neoplasms [C04]
Gender: Female, Male. Age: 18-64 years, 65+ years. Enrolment: 66.
Status: Ended. Start date (EU): 2020-08-14. End date (EU): 2024-10-04. Decision date: 2024-08-13. Results received: No. Last updated: 2024-08-13.

Condition(s): Malignant Peritoneal Mesothelioma

Source: https://euclinicaltrials.eu/ctis-public/view/2024-515343-39-00